EU clinical trial 2022-502123-21-00: Phase 2 Study of MK-6482 in Participants With Advanced Renal Cell Carcinoma
Protocol code: MK-6482-013
Sponsor: Merck Sharp & Dohme LLC (Pharmaceutical company). Phase: Therapeutic exploratory (Phase II). Countries: Ireland (ended), Belgium (ended), Netherlands (ongoing, recruitment ended), Greece (ended).
Therapeutic area(s): Diseases [C] - Neoplasms [C04]
Gender: Female, Male. Age: 18-64 years, 65+ years. Enrolment: 39.
Start date (EU): 2020-12-08. Decision date: 2023-09-20. Results received: No. Last updated: 2026-08-07.
Decision dates by country: IE: 2023-09-20, GR: 2023-11-03, NL: 2023-09-20, BE: 2023-09-26

Condition(s): Advanced Renal Cell Carcinoma
Product: Belzutifan

Primary endpoint: Objective Response Rate (ORR) Per Response Evaluation Criteria in Solid Tumors Version 1.1 (RECIST 1.1) as Assessed by Blinded Independent Central Review (BICR)
Endpoint(s): Progression-Free Survival (PFS) According to Response Evaluation Criteria in Solid Tumors Version 1.1 (RECIST 1.1) as Assessed by Blinded Independent Central Review (BICR), Duration of Response (DOR) Per Response Evaluation Criteria in Solid Tumors Version 1.1 (RECIST 1.1) as Assessed by Blinded Independent Central Review (BICR), Clinical Benefit Rate (CBR) Per Response Evaluation Criteria in Solid Tumors Version 1.1 (RECIST 1.1) as Assessed by Blinded Independent Central Review (BICR), Overall Survival (OS), Number of Participants Who Experience One or More Adverse Events (AEs), Number of Participants Who Discontinue Study Treatment Due to an Adverse Event (AE), Maximum Plasma Concentration (Cmax) of belzutifan, Trough Plasma Concentration (Ctrough) of belzutifan

Source: https://euclinicaltrials.eu/ctis-public/view/2022-502123-21-00